EU clinical trial 2026-525547-32-01: Colchicine Assessment of Low-grade Inflammation and Biomarker Response in Atherosclerosis with Targeted Evaluation
Sponsor: Region Hovedstaden (Hospital/Clinic/Other health care facility). Phase: Therapeutic use (Phase IV). Countries: Denmark (authorised, recruitment pending).
Therapeutic area(s): Diseases [C] - Cardiovascular Diseases [C14]
Gender: Female, Male. Age: 18-64 years, 65+ years. Enrolment: 70.
Status: Authorised, recruitment pending. Decision date: 2026-05-06. Results received: No. Last updated: 2026-05-06.

Condition(s): Ischemic Heart Disease, Coronary Artery Disease, Chronic Coronary Artery Syndrome
Product: COLCHICINE, PLACEBO

Primary endpoint: The primary endpoint is the change in arterial inflammation from baseline to 6 months, assessed by target-to-background ratio (TBR) of [¹⁸F]-FDG PET/CT in the carotid arteries.

Source: https://euclinicaltrials.eu/ctis-public/view/2026-525547-32-01